EU clinical trial 2024-515358-25-00: Investigating the safety, feasibility, and optimal dose of risankizumab-800CW for visualizing drug targeting in Inflammatory Bowel Disease
Protocol code: 20010
Sponsor: Universitair Medisch Centrum Groningen (Hospital/Clinic/Other health care facility). Phase: Phase I and Phase II (Integrated)- First administration to humans. Countries: Netherlands (ended).
Therapeutic area(s): Diseases [C] - Digestive System Diseases [C06]; Diseases [C] - Immune System Diseases [C20]
Gender: Female, Male. Age: 18-64 years, 65+ years. Enrolment: 18.
Status: Ended. Start date (EU): 2024-11-08. End date (EU): 2026-05-19. Decision date: 2024-09-05. Results received: No. Last updated: 2024-09-05.

Condition(s): Inflammatory Bowel Disease (IBD)
Product: Skyrizi 600 mg concentrate for solution for infusion

Primary endpoint: Monitoring of the vital signs before and after tracer administration and evaluating possible (severe) adverse events (SAE & AEs)., Visual evaluation during FME (visible signal yes/no), TBR and CNR calculations, mean fluorescence intensities (MFIs) of biopsies, MDSFR/SFF measurements and fluorescence/ light sheet microscopy.
Endpoint(s): Analysis of in vivo fluorescence images and quantification of fluorescence signals in real-time with spectroscopy, and compare this to endoscopic/histologic inflammation score. We semi-quantify the fluorescence signal in FFPE-biopsies of mucosal tissue. These measurements are compared to the in vivo results of the same bowel section. For patients on treatment, we will look for a possible correlation of in and ex vivo quantified fluorescence and endoscopic/histologic response to risankizumab., Fluorescence signal will be quantified by spectroscopy during endoscopy in all FME inspected bowel segments. The measurements will be compared within all dose groups to determine the optimal dose. Furthermore, spectroscopy measurements will be correlated with fluorescence intensities visualized using the FME camera. Finally, these measurements will be compared with inflammation severity to draw any conclusions about risankizumab distribution into inflamed or non-inflamed tissue., In vivo and ex vivo spectroscopy measurements will be plotted against tracer dose and endoscopic/histopathological inflammation scores. The gastroenterologist evaluates the endoscopic inflammation score during the endoscopy. The histopathological score is determined by an expert pathologist based on an H&E staining of the FFPE biopsies. We hypothesize a positive correlation between the fluorescence signal and the tracer dose and between the fluorescence signal and the inflammation scores., SDS-PAGE with protein extracts of biopsies is used to prove that the fluorescence signal measured originated from the intact tracer. 3D ex vivo fluorescence analysis on biopsies is performed to assess the concentration of risankizumab-800CW in the intact biopsies. Fluorescence microscopy is performed to visualize the tracer signal and perform additional immunofluorescence staining for different immune cells to identify the immune cell type of risankizumab-800CW positive cells.

Source: https://euclinicaltrials.eu/ctis-public/view/2024-515358-25-00